EU clinical trial 2023-507243-11-02: A Multicenter, Randomized, Placebo-Controlled, Parallel Group Trial on the Safety and Efficacy of Istaroxime for Cardiogenic Shock SCAI Stage C (SEISMiC-C)
Protocol code: 04-CL-2201
Sponsor: Windtree Therapeutics Inc. (Pharmaceutical company). Phase: Therapeutic exploratory (Phase II). Countries: Poland (ended), Czechia (ended), Italy (ended).
Therapeutic area(s): Diseases [C] - Cardiovascular Diseases [C14]
Gender: Female, Male. Age: 18-64 years, 65+ years. Enrolment: 80.
Status: Ended. Start date (EU): 2025-01-05. End date (EU): 2025-07-31. Decision date: 2024-12-02. Results received: Yes. Last updated: 2025-05-20.
Decision dates by country: CZ: 2025-05-16, IT: 2025-05-20, PL: 2024-12-02

Condition(s): Cardiogenic Shock
Product: Istaroxime, LActose

Primary endpoint: Systolic blood pressure (SBP) area under the curve (AUC) from start of infusion to 6 hours.
Endpoint(s): Vasoactive-Inotropic Score (VIS) at 24 and 48 hours post baseline. VIS is calculated as doses of dopamine + dobutamine + 100×epinephrine + 50×levosimendan + 10×milrinone + 100×vasopressin + 100×norepinephrine (µg/kg/min), using the dosing rates of vasoactive and inotropic medications., Days alive and out of the hospital through Day 30 from randomization., Time to treatment failure defined by need for initiation of new inotropes or increase in dose of inotropes or mechanical support (circulatory, respiratory, or renal) or death through Day 5 from randomization.

Source: https://euclinicaltrials.eu/ctis-public/view/2023-507243-11-02